EU clinical trial 2023-508738-32-00: Chemotherapy-Free pCR-Guided Strategy with subcutaneous trastuzumabpertuzumab and T-DM1 in HER2-positive early breast cancer (PHERGAIN-2)
Protocol code: MEDOPP293
Sponsor: Medica Scientia Innovation Research S.L. (Pharmaceutical company). Phase: Therapeutic exploratory (Phase II). Countries: Spain (ongoing, recruitment ended), Germany (ongoing, recruitment ended), Hungary (ongoing, recruitment ended), Italy (ongoing, recruitment ended).
Therapeutic area(s): Diseases [C] - Neoplasms [C04]
Gender: Female, Male. Age: 18-64 years, 65+ years. Enrolment: 396.
Status: Ongoing, recruitment ended. Start date (EU): 2021-06-16. Decision date: 2024-09-13. Results received: No. Last updated: 2026-06-23.
Decision dates by country: DE: 2024-09-18, HU: 2024-09-13, IT: 2024-10-07, ES: 2024-09-13

Condition(s): Previously untreated and histologically confirmed HER2-Positive (HER2[+]) early- stage breast cancer
Product: Phesgo 600 mg/600 mg solution for injection, Phesgo 1200 mg/600 mg solution for injection, TRASTUZUMAB EMTANSINE

Primary endpoint: Primary efficacy endpoint: 3y-RFI defined as time from start of treatment in adjuvant setting until recurrence, new invasive disease, or death from breast cancer in the overall population. Recurrence will be defined in accordance with the standardized efficacy endpoints (STEEP) criteria., Primary safety endpoint Global health status decline rate at 1 year from start of neoadjuvant treatment, defined as the rate of patients with a ≥10% global health status decline at 1 year from start of neoadjuvant treatment as assessed by the Global Health Status/QoL EORTC-QLC-C30 scale and its breast cancer module QLQ-BR23.
Endpoint(s): pCR rates (pCRBREAST+LYMPH NODES -ypT0/Tis ypN0- and pCRBREAST -ypT0/Tis-) in the overall study population., pCR rates (pCRBREAST+LYMPH NODES -ypT0/Tis ypN0- and pCRBREAST -ypT0/Tis-) according to HR status (positive, negative), and tumor stage (T1, T2)., RCB score in the overall study population and according to HR status (positive, negative), and tumor stage (T1, T2)., Rate of BCS in the overall study population and according to HR status (positive, negative), and tumor stage (T1, T2), MRI-guided objective response rate by Response Evaluation Criteria in Solid Tumors (RECIST) version (v.)1.1 in the overall study population and according to HR status (positive, negative), and tumor stage (T1, T2), Correlation of MRI-guided objective response rate by RECIST v.1.1 with BCS, pCR, and RCB in the overall study population and according to HR status (positive, negative), and tumor stage (T1, T2)., 5-year RFI in the overall study population and according to study arm (A, B, C), HR status (positive, negative), and tumor stage (T1, T2)., 3-year and 5-year EFS in the overall study population and according to study arm (A, B, C), HR status (positive, negative), and tumor stage (T1, T2)., 3-year and 5-year RFS in the overall study population and according to study arm (A, B, C), HR status (positive, negative), and tumor stage (T1, T2), 3-year and 5-year DRFS in the overall study population and according to study arm (A, B, C), HR status (positive, negative), and tumor stage (T1, T2), 3-year and 5-year DFS in the overall study population and according to study arm (A, B, C), HR status (positive, negative), and tumor stage (T1, T2)., 3-year and 5-year iDFS in the overall study population and according to study arm (A, B, C), HR status (positive, negative), and tumor stage (T1, T2)., 3-year and 5-year OS in the overall study population and according to study arm (A, B, C), HR status (positive, negative), and tumor stage (T1, T2)., 3-year and 5-year BCSS in the overall study population and according to study arm (A, B, C), HR status (positive, negative), and tumor stage (T1, T2)., Adverse events of cardiotoxicity after 1 year of adjuvant treatment according to the NCI-CTCAE v.5.0., Toxicity and safety profile at 3 and 5 years as per NCI-CTCAE v.5.0 in the overall study population and in each study arm (A, B, C)., Patient Reported Outcomes (PROs) HRQoL assessment as per EORTC-QLC-C30 and QLQ-BR23 questionnaires in the overall study population and in each study arm (A, B, C), Ratio of patients of cohort C who will receive adjuvant chemotherapy before T-DM1.

Source: https://euclinicaltrials.eu/ctis-public/view/2023-508738-32-00